EU clinical trial 2025-524169-26-00: An open label multicenter phase II study to investigate the efficacy, safety and tolerability of the Obe-cel in patients with minimal residual disease (MRD) of Philadelphia negative (Ph neg) B-precursor acute lymphoblastic leukaemia (B-ALL) - GMALL-OBECEL
Protocol code: GMALL-OBECEL
Sponsor: Goethe University Frankfurt (Educational Institution). Phase: Therapeutic exploratory (Phase II). Countries: Germany (authorised, recruitment pending).
Therapeutic area(s): Diseases [C] - Hemic and Lymphatic Diseases [C15]
Gender: Female, Male. Age: 18-64 years, 65+ years. Enrolment: 20.
Status: Authorised, recruitment pending. Decision date: 2026-07-20. Results received: No. Last updated: 2026-07-20.

Condition(s): Ph-negative CD19 positive B-precursor ALL patients in CR1 with molecular failure defined as MRD of 10-4 or greater after induction II of front-line therapy
Product: AUTO1

Primary endpoint: Probability of event-free survival (EFS) at 12 months from Obe-cel infusion An event is defined as either death in CR, molecular relapse, morphological relapse, secondary malignancy or start of new anti-B-ALL therapy including allo HSCT.
Endpoint(s): MRD complete response rate (= incidence of MRD negativity) at month 3 after Obe-cel infusion (MRD negativity is confirmed by quantitative evaluation of clonal rearrangements of IG or TR-genes at a sensitivity of at least 10-4 ) defined as percentage of evaluable patients., Incidence of different types of MRD response at 28 days after Obe-cel infusion defined as proportion of evaluable patients (definition MRD response see 12.2.2), Duration of MRD response defined as time from first MRD response to last confirmed continuous MRD response or loss of MRD response, RFS defined as time from CAR T infusion until morphological relapse, or death of any cause, censored at last follow up. Relapse will be defined as the emergence of > 5% abnormal lymphoblasts in the bone marrow, or the emergence of new unequivocal CNS or extramedullary disease after Obe-cel infusion. Patients will be censored for relapse free survival if they undergo allogenic stem cell transplant or receive any other new treatment while in morphologic remission., Median time to molecular or hematologic relapse, Probability of continuous complete remission at 12, 18 and 24 months, Probability of overall survival at 12, 18 and 24 months, Probability of event free survival at 12, 18 and 24 months, Incidence of adverse events categorized by CTCAE 5.0, for CRS and ICANS according to ASTCT consensus grading and proportion of mortality in CR during treatment or follow-up phase, Quantification of immunoglobulines at defined time-points during treatment and follow-up, Rate of allo HSCT in ongoing CR after Obe-cel, Tabular evaluation of hematologic relapse localizations and CD19 expression in case of hematologic relapse, Rate and type of secondary malignancies in relation to evaluable patients, Median and range of duration between inclusion and 1st infusion of Obe-cel, Incidence of different bridging cycles before initiation of Obe-cel in relation to evaluable patients, Incidence of patients not being eligible for Lymphodepletion in relation to evaluable patients, Incidence of withdrawals after only one infusion of Obe-cel in relation to patients receiving the first in fusion, Time to second dose of Obe-cel and description of causes for delays, Total days of hospitalization starting with lymphodepleting regimen, Quantification of Obe-cel at defined time-points (see schedule of assessments) during treatment and follow-up, Quantification of B-cells and B-cell subsets at defined time-points during treatment and follow-up, Number and duration of IVIG substitution(s), Descriptive analysis of all endpoints in relation to patient characteristics, Obi-cel dosing and persistence, conduct of allo HSCT and in comparison, to historic cohorts derived from the GMALL database

Source: https://euclinicaltrials.eu/ctis-public/view/2025-524169-26-00